EU clinical trial 2025-524334-26-01: A Phase 1 Study of BMS-986500 as Monotherapy or Combination Therapy in Advanced Solid Tumors
Protocol code: CA243-0001
Sponsor: Bristol-Myers Squibb Services Unlimited Company (Pharmaceutical company). Phase: Human Pharmacology (Phase I)- First administration to humans. Countries: Denmark (ongoing, recruiting).
Therapeutic area(s): Diseases [C] - Neoplasms [C04]
Gender: Female, Male. Age: 18-64 years, 65+ years. Enrolment: 15.
Status: Ongoing, recruiting. Start date (EU): 2026-03-26. Decision date: 2026-02-26. Results received: No. Last updated: 2026-07-15.

Condition(s): Endometrial cancer (EC), Advanced or metastatic breast cancer, Gastroesophageal cancer (GEC), Advanced or metastatic solid tumors, Platinum-resistant ovarian cancer (PROC), High grade serous ovarian cancer (HGSOC)

Source: https://euclinicaltrials.eu/ctis-public/view/2025-524334-26-01